EU clinical trial 2025-522510-23-00: InsigHHT: A Phase 1/2, Randomized, Double-blind, Placebo-controlled, 2 part Study of the Safety, Tolerability, Efficacy, Pharmacokinetics, and Pharmacodynamics of Single Dose ALN-6400 in Adult Healthy Volunteers and Multiple Dose ALN 6400 in Adult Patients with Hereditary Hemorrhagic Telangiectasia (HHT)
Protocol code: ALN-6400-001
Sponsor: Alnylam Pharmaceuticals Inc. (Pharmaceutical company). Phase: Phase I and Phase II (Integrated)- Other. Countries: France (ongoing, recruitment ended), Spain (ongoing, recruitment ended), Germany (ongoing, recruitment ended).
Therapeutic area(s): Diseases [C] - Congenital, Hereditary, and Neonatal Diseases and Abnormalities [C16]
Gender: Female, Male. Age: 18-64 years, 65+ years. Enrolment: 16.
Status: Ongoing, recruitment ended. Start date (EU): 2025-12-15. Decision date: 2025-11-26. Results received: No. Last updated: 2026-07-09.
Decision dates by country: FR: 2025-11-26, ES: 2025-11-28, DE: 2025-11-27

Condition(s): Hereditary Hemorrhagic Telangiectasia (HHT)
Product: phosphate-buffered saline for SC administration

Primary endpoint: Frequency of AEs. Safety will also be evaluated through vital signs, ECGs, and clinical laboratory assessments.
Endpoint(s): Change from baseline in PLG o Plasma activity levels o Plasma protein levels, Change from baseline in epistaxis o Intensity-adjusted epistaxis duration o ESS o Epistaxis duration o Epistaxis frequency o Epistaxis intensity o Epistaxis-free days per month, • Change from baseline in hematologic parameters o HSS o Iron infusions o RBC transfusions o Hemoglobin, • Change from baseline in QoL/PRO scores o NOSE HHT o mPGI-S

Source: https://euclinicaltrials.eu/ctis-public/view/2025-522510-23-00